EU clinical trial 2024-510845-33-00: A randomized active-controlled trial for vulvovaGinal atRophy in breAst Cancer patients on Endocrine therapy (GRACE-trial)
Protocol code: GRACE
Sponsor: Universitair Ziekenhuis Gent (Hospital/Clinic/Other health care facility). Phase: Therapeutic use (Phase IV). Countries: Belgium (ended).
Therapeutic area(s): Diseases [C] - Neoplasms [C04]
Gender: Female. Age: 18-64 years, 65+ years. Enrolment: 190.
Status: Ended. Start date (EU): 2025-06-23. End date (EU): 2026-03-02. Decision date: 2024-06-27. Results received: No. Last updated: 2025-06-20.

Condition(s): Breast cancer patients on endocrine therapy (AI or SERM) with symptoms of vulvovaginal atrophy
Product: Oekolp 0,03 mg, ovules, Gynoflor Vaginaltabletten, Intrarosa 6.5 mg pessary., Intrarosa 6.5 mg pessary, Intrarosa 6.5 mg pessary., Gynoflor tabletten voor vaginaal gebruik, Gynoflor comprimés vaginaux , Intrarosa 6.5 mg pessary.

Primary endpoint: The primary endpoint of this study is the efficacy of the implemented treatment regimes. Efficacy will be assessed based on patient-reported outcome measurements, being two validated questionnaires: EQ5D-questionnaire (Appendix 1) and the FACT-ES questionnaire (Appendix 2). This endpoint will be assessed at three time points: at start, after 6 weeks, and at the end (after 12 weeks).
Endpoint(s): The secondary endpoint is the safety of the implemented treatments. As a surrogate for safety, blood serum concentration of sex steroid hormones will be determined. This endpoint will be assessed at three time points: at start, after 6 weeks, and at the end (after 12 weeks).

Source: https://euclinicaltrials.eu/ctis-public/view/2024-510845-33-00